EU clinical trial 2023-503815-13-00: A study to test how well different doses of BI 1815368 are tolerated by healthy men
Protocol code: 1485-0002
Sponsor: Boehringer Ingelheim International GmbH (Industry). Phase: Human Pharmacology (Phase I)- Other. Countries: Belgium (ended).
Therapeutic area(s): Diseases [C] - Eye Diseases [C11]
Gender: Male. Age: 18-64 years. Enrolment: 60.
Status: Ended. Start date (EU): 2023-06-19. End date (EU): 2024-06-06. Decision date: 2023-05-30. Results received: No. Last updated: 2024-04-15.

Condition(s): Healthy

Source: https://euclinicaltrials.eu/ctis-public/view/2023-503815-13-00